EU clinical trial 2024-519748-34-00: A Randomized controlled open-label phase II trial assessing the efficacy and safety of two-dosing regimens of frozen encapsulated fecal microbiota transfer products with or without an individualized donor selection approach in decolonizing carriers of multi-drug resistant Enterobacteriaceae (RESET-MDR)
Protocol code: RESET-MDR
Sponsor: Goethe University Frankfurt (Educational Institution). Phase: Therapeutic exploratory (Phase II). Countries: Germany (ongoing, recruiting).
Therapeutic area(s): Diseases [C] - Bacterial Infections and Mycoses [C01]
Gender: Female, Male. Age: 18-64 years, 65+ years. Enrolment: 76.
Status: Ongoing, recruiting. Start date (EU): 2026-01-23. Decision date: 2025-05-09. Results received: No. Last updated: 2026-07-22.

Condition(s): Infections with multidrug-resistant Enterobacteriaceae
Product: COLISTIN SULFATE, INTESTIFIX 001, VANCOMYCIN

Primary endpoint: Detectable intestinal carriage of MDR-E at day 30 in standard qualitative cultural assessment
Endpoint(s): • Comparison of safety and tolerability data between groups via review of nature, frequency and severity of adverse events (AEs), serious AEs (SAEs), and new medical conditions for 30 days, • Characterization of changes in bacterial and fungal intestinal microbiota community structures and taxonomic classification (α- and ß-diversity) at day 0 compared to day 4, 12, 30 and 90, • Comparison of intestinal carriage of MDR-E at day 30 in quantitative cultural assessment, • Characterization and differences of patterns in the intestinal microbiota distribution in patients at baseline compared to day 4, 12, 30 and 90 with and without successful decolonization, • Rate of bacterial infections until day 90, • Rate of MDR-E infections until day 90, • Rate of any type of infection (bacteria, viruses, fungi, parasites) until day 90, • Rate of hospitalization and all-cause mortality until day 90

Source: https://euclinicaltrials.eu/ctis-public/view/2024-519748-34-00